EU clinical trial 2024-519579-24-00: A Randomized, Double-Blind, Multicenter, Placebo-Controlled Study to Evaluate the Safety and Efficacy of Atumelnant in Adult Participants with Classic Congenital Adrenal Hyperplasia
Protocol code: CRN04894-12
Sponsor: Crinetics Pharmaceuticals Inc. (Pharmaceutical company). Phase: Therapeutic confirmatory (Phase III). Countries: Sweden (authorised, recruiting), Austria (ongoing, recruiting), Poland (ongoing, recruiting), Netherlands (authorised, recruiting), Italy (ongoing, recruiting), France (ongoing, recruiting), Germany (authorised, recruiting).
Therapeutic area(s): Diseases [C] - Hormonal diseases [C19]; Diseases [C] - Congenital, Hereditary, and Neonatal Diseases and Abnormalities [C16]
Gender: Female, Male. Age: 18-64 years, 65+ years. Enrolment: 54.
Start date (EU): 2026-02-26. Decision date: 2025-12-02. Results received: No. Last updated: 2026-08-03.
Decision dates by country: IT: 2026-01-23, AT: 2025-12-08, SE: 2025-12-04, FR: 2025-12-02, DE: 2025-12-03, NL: 2025-12-03, PL: 2025-12-08

Condition(s): Classic Congenital Adrenal Hyperplasia
Product: Tablet, Atumelnant 80 mg tablets, Atumelnant 120 mg tablets

Primary endpoint: Proportion of participants with morning post-GC A4 ≤ULN who are on physiologic GC replacement at Week 32
Endpoint(s): Percent change from baseline of morning A4 at Week 2 Percent change from baseline of morning 17-OHP at Week 32 • Proportion of participants with morning pre-GC A4 ≤ULN who are on physiologic GC replacement at Week 32, Percent change from baseline in GC daily dose when morning post-GC A4 ≤ULN at week 32 Addition of exploratory endpoints including some at selected sites.

Source: https://euclinicaltrials.eu/ctis-public/view/2024-519579-24-00